EU clinical trial 2023-505981-26-00: A PHASE III, OPEN-LABEL, RANDOMIZED STUDY TO INVESTIGATE THE EFFICACY AND SAFETY OF ATEZOLIZUMAB (ANTI-PD-L1 ANTIBODY) COMPARED WITH BEST SUPPORTIVE CARE FOLLOWING ADJUVANT CISPLATIN-BASED CHEMOTHERAPY IN PATIENTS WITH COMPLETELY RESECTED STAGE IB-IIIA NON-SMALL CELL LUNG CANCER
Protocol code: GO29527
Sponsor: F. Hoffmann-La Roche AG (Pharmaceutical company). Phase: Therapeutic confirmatory (Phase III). Countries: Netherlands (ongoing, recruitment ended), Spain (ongoing, recruitment ended), Poland (ongoing, recruitment ended), Italy (ongoing, recruitment ended), Germany (ongoing, recruitment ended), France (ongoing, recruitment ended), Hungary (ongoing, recruitment ended), Romania (ended), Portugal (ongoing, recruitment ended).
Therapeutic area(s): Diseases [C] - Neoplasms [C04]
Gender: Female, Male. Age: 18-64 years, 65+ years. Enrolment: 452.
Start date (EU): 2015-11-20. Decision date: 2024-04-26. Results received: No. Last updated: 2026-07-20.
Decision dates by country: RO: 2024-05-08, DE: 2024-04-30, FR: 2024-05-21, HU: 2024-04-26, IT: 2024-05-02, ES: 2024-04-29, PL: 2024-05-02, PT: 2024-04-29, NL: 2024-04-26

Condition(s): Non−Small Cell Lung Cancer
Product: VINORELBINE, DOCETAXEL, CISPLATIN, Tecentriq, GEMCITABINE, PEMETREXED, Tecentriq 1,200 mg concentrate for solution for infusion

Primary endpoint: 1. DFS, defined as the time from randomization to the date of occurrence of any of the following, whichever occurs first: •First recurrence of NSCLC, as determined by the investigator after an integrated assessment of radiographic data, biopsy sample results (if available), and clinical status •Occurrence of new primary NSCLC, as assessed by the investigator •Death from any cause
Endpoint(s): 1. OS, defined as the time from randomization to death from any cause in the ITT population, 2. DFS rates at 3 years and 5 years in the PD-L1-subpopulation and in the Stage II-IIIA population and in the ITT population, 3. DFS in the PD-L1-subpopulation within patients with Stage II-IIIA NSCLC

Source: https://euclinicaltrials.eu/ctis-public/view/2023-505981-26-00